EU clinical trial 2024-517770-14-00: Opioid-Free Analgesia In Intensive Care Unit : A Prospective, Monocentric, Randomized, Double-Blind, Feasibility Clinical Trial
Protocol code: LOCAL/2022/RW-01
Sponsor: Centre Hospitalier Universitaire De Nimes (Hospital/Clinic/Other health care facility). Phase: Therapeutic use (Phase IV). Countries: France (ongoing, recruitment ended).
Therapeutic area(s): Analytical, Diagnostic and Therapeutic Techniques and Equipment [E] - Anesthesia and Analgesia [E03]
Gender: Female, Male. Age: 18-64 years, 65+ years. Enrolment: 50.
Status: Ongoing, recruitment ended. Start date (EU): 2025-11-24. Decision date: 2024-10-17. Results received: No. Last updated: 2025-11-19.

Condition(s): Intubation
Product: NEFOPAM VIATRIS 20 mg/2 ml, solution injectable, TRAMADOL ARROW 100 mg/2 mL, solution injectable/pour perfusion, PARACETAMOL B BRAUN 10 mg/ml, solution pour perfusion, CHLORURE DE SODIUM 0,9 % AGUETTANT, solution pour perfusion, ULTIVA 5 mg, poudre pour solution injectable ou pour perfusion, KETAMINE RENAUDIN 50 mg/ml, solution injectable

Primary endpoint: daily consumption of remifentanil between the 24th hour and the 48th hour after randomisation of patients admitted to the ICU and requiring at least 72 hours of mechanical ventilation
Endpoint(s): Cumulative dose of remifentanil, Number of lived days free of remifentanil, Daily consumption of sedative drugs from inclusion to D28, Number of live days free of mechanical ventilation, SOFA Score (Sepsis-related Organ Failure Assessment), Daily fuid intake in milliliter, CAM ICU test, Presence of one or more events of special interest or expected adverse events: constipation, bradycardia, bladder globe, nausea, vomiting, liver disturbance, serotonin syndrome, Presence of pneumonia associated with mechanical ventilation, Extubation failure and cause (reintubation within 48 hours of first extubation), Length of stay in the intensive care unit and in the hospital, Vital status at day 28 and day 90, Opioid use at D90

Source: https://euclinicaltrials.eu/ctis-public/view/2024-517770-14-00